EU clinical trial 2024-514347-28-00: ANA4CKD - Randomized multicenter double-blind controlled trial comparing anakinra to prednisone for gout flare in patients with chronic kidney disease stage 4-5 or kidney transplantation
Protocol code: APHP180560
Sponsor: Assistance Publique Hopitaux De Paris (Hospital/Clinic/Other health care facility). Phase: Therapeutic confirmatory (Phase III). Countries: France (ended).
Therapeutic area(s): Diseases [C] - Musculoskeletal Diseases [C05]
Gender: Female, Male. Age: 18-64 years, 65+ years. Enrolment: 234.
Status: Ended. Start date (EU): 2022-06-02. End date (EU): 2025-02-12. Decision date: 2024-10-21. Results received: No. Last updated: 2024-10-21.

Condition(s): Men and women over 18 years of age with renal failure renal failure stages 3b/4/5, renal transplantation or dialysis and an untreated gout attack
Product: CORTANCYL 20 mg, comprimé sécable, placebo of Cortancyl 20 mg, NaCl 0,9% as placebo of kineret, Kineret 100 mg/0.67 ml solution for injection in pre-filled syringe.

Primary endpoint: The main evaluation criterion will be the change in pain between the day of inclusion and 3 days after initiation of treatment (D3) or the day of discharge from hospitalization if this occurs before D3.
Endpoint(s): Efficacy of anakinra: To compare changes in pain from baseline to D5, Efficacy of anakinra: To compare speed of resolution of attacks(>80% improvement or pain less than 20 mm), Efficacy of anakinra: To compare treatment response time (more than 50% improvement), Efficacy of anakinra: To compare duration of treatment, Efficacy of anakinra: To compare number of responders (improvement at D3), Efficacy of anakinra: To compare the number of relapses during the study month of the study, • Efficacy of anakinra: To compare consumption of care during the month of the study: length of hospital stay, use of analgesics, length of time off work, Tolerance of anakinra: To compare injection-site reactions, Tolerance of anakinra: To compare decreases in neutrophils or platelets, Tolerance of Anakinra: To compare severe infections, Tolerance of anakinra: To compare decompensation of comorbidities: HTA, diabetes, dyslipidemia, obesity, CKD, •- Tolerance of anakinra: To compare cardiovascular events: myocardial infarction myocardial infarction, arrhythmia, heart failure relapse heart failure, stroke

Source: https://euclinicaltrials.eu/ctis-public/view/2024-514347-28-00